EU clinical trial 2024-512880-30-00: A Phase 3, Multicentre, Double-masked, Randomised Study to Evaluate the Efficacy and Safety of Intravitreal OPT-302 in Combination with Aflibercept, Compared with Aflibercept Alone, in Participants with Neovascular Age-related Macular Degeneration (nAMD)
Protocol code: OPT-302-1005
Sponsor: Opthea Limited (Pharmaceutical company). Phase: Therapeutic confirmatory (Phase III). Countries: Czechia (ended), Bulgaria (ended), Croatia (ended), Netherlands (ended), Poland (ended), Estonia (ended), Hungary (ended), Spain (ended), France (ended), Slovakia (ended), Austria (ended), Lithuania (ended), Germany (ended), Latvia (ended), Greece (ended), Italy (ended).
Therapeutic area(s): Diseases [C] - Eye Diseases [C11]
Gender: Female, Male. Age: 18-64 years, 65+ years. Enrolment: 475.
Status: Ended. Start date (EU): 2021-08-27. End date (EU): 2025-03-31. Decision date: 2024-08-28. Results received: Yes. Last updated: 2025-04-23.
Decision dates by country: AT: 2024-09-15, HR: 2024-09-02, CZ: 2024-08-30, EE: 2024-09-02, DE: 2024-08-30, GR: 2024-11-13, HU: 2024-08-28, LV: 2024-09-02, LT: 2024-09-06, NL: 2024-08-29, PL: 2024-08-30, SK: 2024-09-02, ES: 2024-08-28, IT: 2024-12-20, BG: 2024-09-16, FR: 2024-08-30

Condition(s): Neovascular Age-related Macular Degeneration (wet AMD)
Product: Eylea 40 mg/mL solution for injection in pre-filled syringe, Eylea 40 mg/mL solution for injection in pre-filled syringe, Sham injection, intravitreal use, mimic OPT-302 injection, Eylea 40 mg/mL solution for injection in pre-filled syringe, OPT-302, Eylea 40 mg/mL solution for injection in pre-filled syringe

Primary endpoint: Mean change from Baseline to Week 52 in Early Treatment Retinopathy Study (ETDRS) best-corrected visual acuity (BCVA) letters.
Endpoint(s): Efficacy: - Proportion of participants gaining 15 or more ETDRS BCVA letters from Baseline to Week 52 - Proportion of participants gaining 10 or more ETDRS BCVA letters from Baseline to Week 52, - Change in CNV area by fluorescein angiography (FA) from Baseline to Week 52 - Proportion of participants with absence of both SRF and IR cysts by spectral domain optical coherence tomography (SD-OCT) at Week 52

Source: https://euclinicaltrials.eu/ctis-public/view/2024-512880-30-00